EU clinical trial 2024-513297-21-00: Phase II study of Short-course radiotherapy followed by consolidation chemotherapy with the Triplet FOLFOXIRI as total neoadjuvant therapy for locally advanced rectal cancer: the ShorTrip trial
Protocol code: ShorTrip
Sponsor: Fondazione GONO G.I. (Patient organisation/association). Phase: Therapeutic exploratory (Phase II). Countries: Italy (ongoing, recruitment ended).
Therapeutic area(s): Diseases [C] - Neoplasms [C04]
Gender: Female, Male. Age: 18-64 years, 65+ years. Enrolment: 63.
Status: Ongoing, recruitment ended. Start date (EU): 2022-01-14. Decision date: 2024-11-19. Results received: No. Last updated: 2026-06-03.

Condition(s): Locally advanced rectal cancer
Product: FLUOROURACIL, OXALIPLATIN, CALCIUM LEVOFOLINATE, IRINOTECAN

Primary endpoint: Pathological complete response (pCR) rate, defined as the percentage of patients, relative to the total of enrolled subjects, with the absence of residual tumour cells in the resected specimens. pCR will be assessed by tumour regression grade according to Dworak et al, at the histopathological exam
Endpoint(s): Overall toxicity rate, defined as the percentage of patients, relative to the total of enrolled subjects, who receive radiotherapy and at least one cycle of chemotherapy, experiencing any adverse event, according the RTOGTC during SCRT, and according to National Cancer Institute Common Toxicity Criteria (version 5.0), during the consolidation chemotherapy, G3/4 toxicity rate, is defined as the percentage of patients, relative to the total of enrolled subjects, who receive radiotherapy and at least one cycle of chemotherapy, experiencing a specific adverse event of grade 3/4, according the RTOGTC during SCRT, and according to National Cancer Institute Common Toxicity Criteria (version 5.0), during the consolidation chemotherapy., R0 Resection Rate is defined as the percentage of patients, relative to the total of enrolled subjects, undergoing R0 resection of primary tumour. R0 surgery is defined as microscopically margin-negative resection at the histopatological exam, Failure-free survival (FFS) is defined as the time from enrollment to one of the following events: non-radical surgery (non R0/R1) of the primary tumour, intrapelvic recurrence after R0/1 resection of the primary tumour, distant relapse, second primary tumour or death from any cause, whichever occurred first., Overall Survival (OS) is defined as the time from enrolment to death from any cause. For patients still alive at the time of analysis, the OS time will be censored on the last date the patients were known to be alive., Time to distant metastases, is defined as the time from enrolment to the radiological evidence of distant metastases. The determination of the evidence of distant metastases will be based on investigator-reported measurements. Patients who are died or alive without having distant metastases at the end of the study will be censored at the date of death or their last radiological assessment, respectively., Time to locoregional failure is defined as the time from the enrolment to non-radical surgery of the primary tumour (non R0/R1 resection) or intrapelvic recurrence after R0/1 resection of the primary tumour. The determination of the intrapelvic recurrence will be based on investigator-reported assessment., Clinical complete response (cCR) rate, defined as the percentage of patients, relative to the total of enrolled subjects, with the absence of residual tumour (cT0cN0) at the radiological and endoscopic staging after neoadjuvant treatment., Major pathological response (MPR) rate, defined as the percentage of patients, relative to the total enrolled subjects, achieving TRG1-2 sec Mandard or TRG3-4 sec Dworak at the histopathological exam, Surgical mortality, defined as the percentage of patients, relative to the total of enrolled subjects, experiencing death within 30 days after the surgery, Surgical morbidities, defined as the percentage of patients, relative to the total of enrolled subjects, experiencing any post-operative complications within 30 days after the surgery, Quality of Life, (QoL) assessed using the EORTC QLQ-C30, the EORTC QLQ-CR29 and the EuroQol EQ-5D questionnaires, and Rectal Continence, assessed using LARS and St. Mark Continence scores, will be evaluate at specific time-points (baseline, after radiotherapy and chemotherapy, after surgery and during follow-up) and will be assessed through descriptive summary statistics.

Source: https://euclinicaltrials.eu/ctis-public/view/2024-513297-21-00